EU clinical trial 2024-516879-32-00: A Randomized, Double-Blind, Placebo-Controlled Clinical Trial Evaluating the Efficacy of Transfer Factor TFI Treatment by Assessing the Number of New Infections in Subjects with Recurrent Respiratory or Urinary Tract Infections or Recurrent Herpetic Infections Recorded over a Period of 6 Months from Randomization
Sponsor: Aumed a.s. (Pharmaceutical company). Phase: Therapeutic confirmatory (Phase III). Countries: Czechia (ongoing, recruitment ended).
Therapeutic area(s): Diseases [C] - Bacterial Infections and Mycoses [C01]; Diseases [C] - Virus Diseases [C02]
Gender: Female, Male. Age: 18-64 years. Enrolment: 100.
Status: Ongoing, recruitment ended. Start date (EU): 2025-06-13. Decision date: 2025-01-08. Results received: No. Last updated: 2026-04-01.

Condition(s): • Recurrent respiratory infections; • Recurrent urinary tract infections; • Recurrent herpetic infections

Source: https://euclinicaltrials.eu/ctis-public/view/2024-516879-32-00